EU clinical trial 2024-515576-12-00: A randomized, double blind, placebo controlled, Proof of Concept (PoC) study to assess the efficacy, safety and tolerability of itepekimab in participants with inadequately controlled chronic rhinosinusitis without nasal polyps
Protocol code: ACT18421
Sponsor: Sanofi-Aventis Recherche & Developpement (Pharmaceutical company). Phase: Therapeutic exploratory (Phase II). Countries: Portugal (ended), Poland (ongoing, recruitment ended), Italy (ongoing, recruitment ended), Romania (ended), Spain (ongoing, recruitment ended), France (ended), Belgium (ongoing, recruitment ended).
Therapeutic area(s): Diseases [C] - Respiratory Tract Diseases [C08]
Gender: Female, Male. Age: 18-64 years, 65+ years. Enrolment: 53.
Start date (EU): 2025-03-20. Decision date: 2025-02-11. Results received: No. Last updated: 2026-08-04.
Decision dates by country: RO: 2025-02-14, PT: 2025-03-17, FR: 2025-04-07, BE: 2025-02-11, ES: 2025-02-11, PL: 2025-02-17, IT: 2025-02-12

Condition(s): Respiratory tract diseases
Product: Itepekimab, Matched placebo for test product

Primary endpoint: Change from baseline in sinus (maxillary, ethmoid) percent opacification volume assessed by CT scan
Endpoint(s): Change from baseline in the sTSS, Change from baseline in nasal congestion (NC) severity score, Anterior/posterior rhinorrhea severity score, Facial pain/pressure severity score, and Loss of smell severity score using the CRSsNP daily e diary, Change from baseline in SNOT-22 total score, Change from baseline in sinus opacification as measured by the Lund-Mackay (LMK) score and the modified LMK score, Incidence of (treatment-emergent adverse events (TEAEs), treatment-emergent adverse events of special interest (TEAESIs), treatment emergent serious adverse events (TESAEs), and treatment-emergent adverse events (TEAEs) leading to intervention discontinuation, Itepekimab concentration in serum, Incidence of treatment-emergent (TE) anti-itepekimab antibodies responses

Source: https://euclinicaltrials.eu/ctis-public/view/2024-515576-12-00